EU clinical trial 2023-510527-29-00: ProTarget - A Danish Nationwide Clinical Trial on Targeted Anti‐Cancer Treatment based on Genomic Profiling
Sponsor: Rigshospitalet (Hospital/Clinic/Other health care facility). Phase: Therapeutic exploratory (Phase II). Countries: Denmark (ongoing, recruiting).
Therapeutic area(s): Diseases [C] - Neoplasms [C04]
Gender: Female, Male. Age: 18-64 years, 65+ years. Enrolment: 600.
Status: Ongoing, recruiting. Start date (EU): 2020-09-01. Decision date: 2024-05-16. Results received: No. Last updated: 2026-07-23.

Condition(s): Cancer
Product: Lynparza 100 mg film-coated tablets, Herceptin 150 mg powder for concentrate for solution for infusion, Zejula 100 mg film-coated tablets, Perjeta 420 mg concentrate for solution for infusion, Pemazyre 4.5 mg tablets, Lynparza 150 mg film-coated tablets, Cotellic 20 mg film-coated tablets, Zelboraf 240 mg film-coated tablets

Primary endpoint: Anti-tumor activity, as assessed by objective response at 16 weeks, Stable disease at 16 weeks, Treatment-related and serious adverse events
Endpoint(s): Duration of response, progression-free and overall survival, Duration of treatment on study (time on drug), Percentage of patients that are treated based on their molecular tumor profile, Description of concordance between mutational profile of pre-treatment tumor biopsies and mutational profile according to tumor profiling tests that were used to enroll patients, Identification of patterns of resistance based on serial tumor biopsies and liquid biopsies

Source: https://euclinicaltrials.eu/ctis-public/view/2023-510527-29-00